EU clinical trial 2023-505917-25-00: Neoadjuvant pembrolizumab plus chemotherapy in locally advanced sinonasal carcinoma (NeoPeSino)
Protocol code: NeoPeSino
Sponsor: Istituti Clinici Scientifici Maugeri In Forma Abbreviata Istituti Clinici Scientifici Maugeri O Anche Ics Maugeri O Maugeri S.p.A. Sb (Hospital/Clinic/Other health care facility). Phase: Therapeutic exploratory (Phase II). Countries: Italy (ongoing, recruiting).
Therapeutic area(s): Diseases [C] - Otorhinolaryngologic Diseases [C09]
Gender: Female, Male. Age: 18-64 years, 65+ years. Enrolment: 28.
Status: Ongoing, recruiting. Start date (EU): 2024-11-05. Decision date: 2023-10-27. Results received: No. Last updated: 2025-02-12.

Condition(s): Locally advanced sinonasal carcinoma
Product: KEYTRUDA 25 mg/mL concentrate for solution for infusion

Primary endpoint: Neoadjuvant therapy objective response rate (ORR, defined as the sum of complete remission (CRs) and partial responses (PRs) by RECIST v. 1.1 criteria will serve as the primary efficacy endpoint.

Source: https://euclinicaltrials.eu/ctis-public/view/2023-505917-25-00